EU clinical trial 2024-513919-27-00: A Multicenter, Open-label, Long Term Extension Study to Assess the Safety and Efficacy of Filgotinib in Subjects with Rheumatoid Arthritis
Protocol code: GS-US-417-0304
Sponsor: Alfasigma S.p.A. (Pharmaceutical company). Phase: Therapeutic confirmatory (Phase III). Countries: Bulgaria (ended), Hungary (ended), Germany (ended).
Therapeutic area(s): Diseases [C] - Musculoskeletal Diseases [C05]
Gender: Female, Male. Age: 18-64 years, 65+ years. Enrolment: 254.
Status: Ended. Start date (EU): 2017-09-14. End date (EU): 2025-04-15. End date: 2025-05-16. Decision date: 2024-07-11. Results received: Yes. Last updated: 2025-02-27.
Decision dates by country: DE: 2024-07-11, HU: 2024-07-15, BG: 2024-07-12

Condition(s): Rheumatoid arthritis
Product: Jyseleca 100 mg film-coated tablets, Jyseleca 200 mg film-coated tablets

Primary endpoint: Safety, evaluated through AEs, clinical laboratory tests, and vital signs.
Endpoint(s): ACR-N responses in each arm.

Source: https://euclinicaltrials.eu/ctis-public/view/2024-513919-27-00